EU clinical trial 2023-505772-30-00: A Phase 3 Trial of Fianlimab (REGN3767, Anti-Lag-3) + Cemiplimab versus Pembrolizumab in Patients with Previously Untreated Unresectable Locally Advanced or Metastatic Melanoma
Protocol code: R3767-ONC-2011
Sponsor: Regeneron Pharmaceuticals Inc. (Pharmaceutical company). Phase: Therapeutic confirmatory (Phase III). Countries: Ireland (ongoing, recruitment ended), Austria (ongoing, recruitment ended), Germany (ongoing, recruitment ended), Spain (ongoing, recruitment ended), Romania (ongoing, recruitment ended), Poland (ongoing, recruitment ended), Italy (ongoing, recruitment ended), Hungary (ongoing, recruitment ended), Netherlands (ongoing, recruitment ended), France (ongoing, recruitment ended), Czechia (ongoing, recruitment ended), Belgium (ongoing, recruitment ended).
Therapeutic area(s): Diseases [C] - Neoplasms [C04]
Gender: Female, Male. Age: 0-17 years, 18-64 years, 65+ years. Enrolment: 562.
Status: Ongoing, recruitment ended. Start date (EU): 2022-11-09. Decision date: 2024-03-07. Results received: No. Last updated: 2026-07-06.
Decision dates by country: BE: 2024-03-28, FR: 2024-03-20, HU: 2024-03-08, RO: 2024-03-12, PL: 2024-03-25, AT: 2024-04-22, NL: 2024-03-07, ES: 2024-03-11, CZ: 2024-03-12, DE: 2024-03-11, IE: 2024-03-07, IT: 2024-03-25

Condition(s): Melanoma
Product: Placebo for Fianlimab, KEYTRUDA 25 mg/mL concentrate for solution for infusion, Fianlimab, LIBTAYO 350 mg concentrate for solution for infusion.

Primary endpoint: Progression-free survival (PFS)
Endpoint(s): Overall survival (OS), Objective response rate (ORR), Disease control rate (DCR), Duration of response (DoR), PFS per investigator assessment, Incidence of Adverse Events (AEs), Occurrence of interruption and discontinuation of study drug(s) due to AEs, TEAEs leading to death, Incidence of laboratory abnormalities, Concentrations of cemiplimab in serum, Concentrations of fianlimab in serum, Incidence of anti-drug antibodies (ADA) to fianlimab over time, Titer of anti-drug antibodies (ADA) to fianlimab over time, Incidence of ADA to cemiplimab over time, Titer of ADA to cemiplimab over time, Incidence of neutralizing antibodies (NAb) to fianlimab over time, Incidence of NAb to cemiplimab over time, Patient-reported outcomes (PROs) as measured by European Organization for Research and Treatment of Cancer Quality of Life Questionnaire C30 (EORTC QLQ-C30), PROs as measured by EQ-5D-5L, PROs as measured by Functional Assessment of Cancer Therapy (FACT)-melanoma (melanoma subscale only), PROs as measured by Patient Global Impression of Severity (PGIS), PROs as measured by Patient Global Impression of Change (PGIC), Change in physical functioning per EORTC QLQ-C30, Change in role functioning per EORTC QLQ-C30, Change in global health status/quality of life (GHS/QoL) per EORTC QLQ-C30, Change in physical functioning per EORTC QLQ-C30, Change in role functioning per EORTC QLQ-C30, Change in GHS/QoL per EORTC QLQ-C30

Source: https://euclinicaltrials.eu/ctis-public/view/2023-505772-30-00